EU clinical trial 2023-506478-11-01: IMMUNE RESET TO ALLOW ACCESS TO HLA-COMPATIBLE KIDNEY TRANSPLANTATION IN HYPERIMMUNIZED PATIENTS
Protocol code: HIPER-RESET
Sponsor: Fundacio Hospital Universitari Vall D’Hebron Institut De Recerca (Laboratory/Research/Testing facility). Phase: Phase I and Phase II (Integrated)- Other. Countries: Spain (ongoing, recruitment ended).
Therapeutic area(s): Phenomena and Processes [G] - Immune system processes [G12]
Gender: Female, Male. Age: 18-64 years. Enrolment: 10.
Status: Ongoing, recruitment ended. Start date (EU): 2025-08-28. Decision date: 2023-11-21. Results received: No. Last updated: 2025-08-28.

Condition(s): chronic kidney disease, Hypersensitized patients

Source: https://euclinicaltrials.eu/ctis-public/view/2023-506478-11-01